EU clinical trial 2024-519759-27-00: Efficacy of Higher vs. Lower Doses of Dexamethasone in Patients With Acute Hypoxemic Respiratory Failure (Including ARDS) Caused by Infections (Including COVID-19)
Protocol code: DEXA-REFINE-COVID-19
Sponsor: Consorcio Centro De Investigacion Biomedica En Red (Laboratory/Research/Testing facility). Phase: Therapeutic use (Phase IV). Countries: Spain (ongoing, recruiting).
Therapeutic area(s): Diseases [C] - Respiratory Tract Diseases [C08]
Gender: Female, Male. Age: 18-64 years, 65+ years. Enrolment: 980.
Status: Ongoing, recruiting. Start date (EU): 2024-12-20. Decision date: 2024-12-20. Results received: No. Last updated: 2024-12-20.

Condition(s): Acute Hypoxemic Respiratory Failure
Product: Dexametasona Kern Pharma 7,2 mg solución inyectable

Primary endpoint: All-cause hospital mortality.
Endpoint(s): Number of ventilator free-days (VFDs) at Day 28 (defined as days alive and free from mechanical ventilation at day 28 after intubation. For subjects ventilated >=28 days and for subjects who die, VFD is 0., Mortality at ICU and at Day 28., Duration (in days) on mechanical ventilation., Length of stay (in days) in the hospital for survivors., Time (in days) from treatment initiation to death., Proportions with viral RNA detection over time.

Source: https://euclinicaltrials.eu/ctis-public/view/2024-519759-27-00